EU clinical trial 2022-501104-10-00: Evasayil TM: A placebo-controlled trial to evaluate the efficacy and safety of spesolimab in the treatment of patients with Netherton syndrome
Protocol code: 1368-0104
Sponsor: Boehringer Ingelheim International GmbH, Boehringer Ingelheim Espana S.A., Boehringer Ingelheim RCV GmbH & Co. KG (Pharmaceutical company). Phase: Phase II and Phase III (Integrated). Countries: Spain (ended), Belgium (ended), Bulgaria (ended), Germany (ended), Italy (ended), Finland (ended), Portugal (ended), Czechia (ended), Austria (ended), Netherlands (ended), France (ended).
Therapeutic area(s): Diseases [C] - Congenital, Hereditary, and Neonatal Diseases and Abnormalities [C16]; Diseases [C] - Skin and Connective Tissue Diseases [C17]
Gender: Female, Male. Age: 0-17 years, 18-64 years, 65+ years. Enrolment: 20.
Status: Ended. Start date (EU): 2023-06-06. End date (EU): 2025-07-31. End date: 2025-08-01. Decision date: 2023-04-25. Results received: Yes. Last updated: 2025-06-16.
Decision dates by country: CZ: 2023-05-02, AT: 2023-05-30, ES: 2023-04-28, BE: 2023-04-25, FI: 2023-05-02, BG: 2023-05-02, NL: 2023-04-25, PT: 2023-04-28, DE: 2023-04-26, IT: 2023-05-02, FR: 2023-05-02

Condition(s): Netherton syndrome (NS)
Product: Placebo for BI 655130 (solution for injection), Spesolimab, Placebo for BI 655130 (solution for infusion)

Primary endpoint: IASI response, defined as a decrease of at least 50 % absolute change in IASI score from baseline (Yes/No).
Endpoint(s): Key secondary endpoint: IGA response, defined as a decrease of at least 1-grade absolute change in IGA score from baseline, IGA score of 0 or 1, IASI response, IASI-E subscore response, IASI-S subscore response, Percent change from baseline in IASI score, Absolute change from baseline in NRS pain, Absolute change from baseline in NRS itch, Absolute change from baseline in DLQI score, Absolute change from baseline in CDLQI score, The occurrence of treatment emergent adverse events including serious and/or opportunistic infections

Source: https://euclinicaltrials.eu/ctis-public/view/2022-501104-10-00